EU clinical trial 2024-514426-23-01: A Phase 1, Open-Label, Multiple-Part Trial to Evaluate the Drug-Drug Interaction Potential of PRAX-628 in Healthy Participants
Protocol code: PRAX-628-102
Sponsor: Praxis Precision Medicines Inc. (Pharmaceutical company). Phase: Human Pharmacology (Phase I)- Other. Countries: Netherlands (ended).
Therapeutic area(s): Diseases [C] - Nervous System Diseases [C10]
Gender: Female, Male. Age: 18-64 years. Enrolment: 62.
Status: Ended. Start date (EU): 2024-08-28. End date (EU): 2025-02-24. Decision date: 2024-08-21. Results received: No. Last updated: 2024-12-06.

Condition(s): Epilepsy

Source: https://euclinicaltrials.eu/ctis-public/view/2024-514426-23-01